EU clinical trial 2024-519184-18-00: An open-label, phase I/II first-in-human, dose escalation and confirmation study to evaluate the safety, tolerability, pharmacokinetic, pharmacodynamic and anti-tumour activity of IPN01195 as single agent in adult participants with advanced solid tumours
Protocol code: CLIN-01195-450
Sponsor: Ipsen Pharma (Pharmaceutical company). Phase: Phase I and Phase II (Integrated)- First administration to humans. Countries: Spain (ongoing, recruiting), France (ongoing, recruiting), Italy (ongoing, recruiting).
Therapeutic area(s): Diseases [C] - Neoplasms [C04]
Gender: Female, Male. Age: 18-64 years, 65+ years. Enrolment: 26.
Status: Ongoing, recruiting. Start date (EU): 2025-05-30. Decision date: 2025-04-22. Results received: No. Last updated: 2026-08-03.
Decision dates by country: IT: 2025-04-23, ES: 2025-04-22, FR: 2025-04-22

Condition(s): Advanced Solid Tumour
Product: IPN01195, IPN01195

Primary endpoint: Part A: Percentage of participants with dose limiting toxicity (DLT) [Time Frame: Part A: within 28 days of first dose.], Part A and B: Percentage of participants experiencing emergent serious adverse events (TE SAEs). [Time Frame: From the first IPN01195 administration to 30 days after last dose.], Part A and B: Percentage of participants with dose interruptions and permanent treatment discontinuations [Time Frame: From the first study drug administration to 30 days after last dose.], Part B: Objective response rate (ORR) Objective response rate is defined as the percentage of participants with best overall response (BOR) of complete response (CR) or partial response (PR) as determined by investigator per RECIST version 1.1. [Time Frame: Part B: At end of study (up to approximately 3 years)]
Endpoint(s): Part A: Time to maximum observed drug concentration (Tmax) after single and multiple doses of IPN01195 [Time Frame: Cycle 1: at Day 1 and at Day 15.], Part A: Maximum observed drug concentration (Cmax) after single and multiple doses of IPN01195 [Time Frame: Cycle 1: at Day 1 and at Day 15.], Part A: Area under the plasma concentration time curve (AUCtau) after single and multiple doses of IPN01195 AUCtau is defined as the concentration of drug over one dosing interval. [Time Frame: Cycle 1: at Day 1 and at Day 15.], Part A: Geometric mean ratio of Cmax of IPN01195 administered in fed state relative to fasted state. [Time Frame: Between Day -8 and Day -3 (fasted period) and between Day -10 and Day -7 (fed state period)], Part A: Geometric mean ratio of AUClast of IPN01195 administered in fed state relative to fasted state AUClast is defined as the concentration of drug from time zero to the last observable concentration. [Time Frame: Between Day -8 and Day -3 (fasted period) and between Day -10 and Day -7 (fed state period)], Part A: Geometric mean ratio of AUCinf of IPN01195 administered in fed state relative to fasted state AUCinf is defined as the concentration of drug extrapolated to infinite time. [Time Frame: Between Day -8 and Day -3 (fasted period) and between Day -10 and Day -7 (fed state period)], Part A: Prolongation of corrected QT interval (QTc) Prolongation of QTc defined as the upper limit of 90% confidence interval for change from baseline QTc evaluated over Cycle 1 at the highest clinically relevant exposure. [Time Frame: Within 28 days of first dose.], Part A: Objective response rate (ORR) The ORR is defined as the percentage of participants with best overall response (BOR) of complete response (CR) or partial response (PR) as determined by investigator per RECIST version 1.1 [Time Frame: Part A: From first study drug administration to end of study (up to approximately 3 years)], Part B: Duration of response (DoR) DoR defined as the time from first documented evidence of CR or PR until progressive disease, as determined by investigator per RECIST version 1.1. [Time Frame: Every 3 months until end of study or death (up to approximately 3 years)], Part B: Progression-free survival (PFS) PFS is defined as the time from the date of first IPN01195 administration to the date of the first documented disease progression, as determined by investigator per RECIST version 1.1. [Time Frame: From first study drug administration to end of study (up to approximately 3 years)], Part B: PFS rate at 4 months PFS rate at 4 months defined as the proportion of participants who remain alive and progression-free at 4 months, as determined by investigator per RECIST version 1.1. [Time Frame: At Month 4], Part B: Disease control rate (DCR). DCR is defined as the percentage of participants with BOR of CR, PR or stable disease (SD), as determined by investigator per RECIST version 1.1 [Time Frame: Part B:From first study drug administration to end of study (up to approximately 3 years)]

Source: https://euclinicaltrials.eu/ctis-public/view/2024-519184-18-00